EU clinical trial 2023-507781-13-00: Safety, pharmacokinetics, and preliminary efficacy of BYON4413 in acute myeloid leukemia and myelodysplastic neoplasms.
Protocol code: BYON4413.001
Sponsor: Byondis B.V. (Pharmaceutical company). Phase: Human Pharmacology (Phase I)- First administration to humans. Countries: Spain (ended), Netherlands (ended), Belgium (ended).
Therapeutic area(s): Diseases [C] - Neoplasms [C04]; Diseases [C] - Hemic and Lymphatic Diseases [C15]
Gender: Female, Male. Age: 18-64 years, 65+ years. Enrolment: 33.
Status: Ended. Start date (EU): 2024-05-24. End date (EU): 2025-09-30. Decision date: 2024-04-30. Results received: No. Last updated: 2025-09-19.
Decision dates by country: BE: 2024-04-30, ES: 2024-04-30, NL: 2024-05-03

Condition(s): Patients with relapsed/refractory acute myeloid leukemia or myelodysplastic neoplasms

Source: https://euclinicaltrials.eu/ctis-public/view/2023-507781-13-00